EU clinical trial 2025-522698-13-00: Phase IV open-label clinical trial of the immunogenicity and safety of standard dose trivalent inactivated influenza vaccine (Influvac) in a population of people with obesity
Sponsor: Region Stockholm – SLSO (Hospital/Clinic/Other health care facility). Phase: Therapeutic use (Phase IV). Countries: Sweden (authorised, recruitment pending).
Therapeutic area(s): Diseases [C] - Virus Diseases [C02]
Gender: Female, Male. Age: 18-64 years. Enrolment: 120.
Status: Authorised, recruitment pending. Decision date: 2025-12-23. Results received: No. Last updated: 2026-07-08.

Condition(s): Influenza, Obesity, Type 2 diabetes
Product: Influvac injektionsvätska, suspension, förfylld spruta (influensavaccin, ytantigen, inaktiverat)

Primary endpoint: Hemaglutinnin Inhibition Assay GMTs at day 0 (pre-vaccination) and at 14 days post-vaccination with Influvac., The proportion of participants achieving a protective hemagluttinin inhibition assay titre ≥40 at 14 days post-vaccination., The proportion of participants achieving a four-fold rise in hemagluttinin inhibition assay titre at 14 days post-vaccination.
Endpoint(s): Incidence of solicited local (injection site) and systemic AEs in the 7-days post-vaccination., Incidence of SAEs, unsolicited AEs and fatal AEs during the period of the study.

Source: https://euclinicaltrials.eu/ctis-public/view/2025-522698-13-00